EU clinical trial 2024-518128-66-00: A Proof of Concept Study Non-Randomized, Single-Center Pilot Trial Assessing The Safety/Efficacy Of Dual Targeting Of Peripheral And Central Humoral Alloimmune Memory With Anti-CD38 (Daratumumab) And Costimulation Blockade With CTLA4-Ig (Belatacept) In Highly HLA-Sensitized Patients Awaiting Kidney Transplantation
Protocol code: 38RC21.171 COMBAT
Sponsor: Centre Hospitalier Universitaire Grenoble Alpes (Hospital/Clinic/Other health care facility). Phase: Human Pharmacology (Phase I)- Other. Countries: France (ended).
Therapeutic area(s): Analytical, Diagnostic and Therapeutic Techniques and Equipment [E] - Therapeutics [E02]
Gender: Female, Male. Age: 18-64 years, 65+ years. Enrolment: 15.
Status: Ended. Start date (EU): 2022-01-11. End date (EU): 2025-04-22. Decision date: 2024-11-08. Results received: No. Last updated: 2024-11-08.

Condition(s): patients with cPRA or TGI ≥ 95% on the deceased donor kidney transplant waiting list, who have not received a compatible donor offer for ≥1 year.

Source: https://euclinicaltrials.eu/ctis-public/view/2024-518128-66-00